EU clinical trial 2025-525039-15-01: A study to evaluate how well single and multiple doses of S072 are tolerated in healthy adult participants
Sponsor: Sea4us Biotecnologia E Recursos Marinhos S.A. (Pharmaceutical company). Phase: Human Pharmacology (Phase I)- First administration to humans. Countries: Spain (ongoing, recruiting).
Therapeutic area(s): Analytical, Diagnostic and Therapeutic Techniques and Equipment [E] - Anesthesia and Analgesia [E03]
Gender: Female, Male. Age: 18-64 years. Enrolment: 64.
Status: Ongoing, recruiting. Start date (EU): 2026-05-25. Decision date: 2026-04-16. Results received: No. Last updated: 2026-05-22.

Condition(s): Pain

Source: https://euclinicaltrials.eu/ctis-public/view/2025-525039-15-01